EU clinical trial 2023-509861-19-01: Combining Loncastuximab Tesirine and Epcoritamab in Relapsed/Refractory Diffuse Large B-cell Lymphoma (DLBCL)
Protocol code: WWU23_0006
Sponsor: Universitaet Muenster (Educational Institution). Phase: Therapeutic exploratory (Phase II). Countries: Germany (ongoing, recruiting).
Therapeutic area(s): Diseases [C] - Neoplasms [C04]
Gender: Female, Male. Age: 18-64 years, 65+ years. Enrolment: 104.
Status: Ongoing, recruiting. Start date (EU): 2025-09-30. Decision date: 2025-09-15. Results received: No. Last updated: 2026-07-02.

Condition(s): Diffuse large B-cell lymphoma (DLBCL), Follicular lymphoma (FL) grade 3B, High-grade B-cell lymphoma (HGBL)
Product: Zynlonta 10 mg powder for concentrate for solution for infusion, Epcoritamab (GEN3013), Epcoritamab (GEN3013)

Primary endpoint: The primary efficacy endpoint is the BORR defined as the proportion of patients with r/r DLBCL, HGBL and FL grade 3B who achieve a complete or partial remission as best response up to 12-months of study treatment according to the 2014 Lugano criteria, as assessed by local investigator review
Endpoint(s): 2-year progression-free survival (PFS) with a 95% confidence interval. PFS is defined as time from the first dose of study drug until one of the following events occurs, whichever is first: Disease progression, Relapse, Death due to any cause. Patients who have not experienced an event at the time of analysis will be censored at the most recent date of disease assessment, 2-year overall survival (OS) defined as the time from the first dose of study drug to death of any cause. Patients who have not experienced an event at the time of analysis will be censored at the last date known to be alive., Complete response (CR) rate measured as the number of complete remissions as best response (achieved up to 12 months) divided by the number of patients treated with at least one dose of study drug, Partial response (PR) rate measured as the number of partial remissions as best response (achieved up to 12 months) divided by the number of patients treated with at least one dose of study drug, Time to complete response measured as the time from the start of therapy to documentation of complete remission, Time to best response (achieved up to 12 months) measured as the time from the start of therapy to documentation of the best tumor response according to type of response, Duration of response measured as the time from documentation of tumor response (complete or partial remission) to relapse or progressive disease, BORR defined as the best overall response of complete or partial remission after 18- and 24-months of treatment, Progression rate measured as the number of progressions (observed up to 12 months) divided by the number of patients treated with at least one dose of study drug, Relapse rate measured as the number of relapses divided by the number of patients included with complete or partial remission, Outcomes according to biological characteristics of the lymphoma, Adverse Events, Serious Adverse Events, Rate of treatment-related deaths defined as the number of treatment-related deaths during therapy or up to 2 months after the end of therapy divided by the number of patients included, Number of treatment cycles received, Duration of treatment cycles, Cumulative doses of loncastuximab tesirine and epcoritamab

Source: https://euclinicaltrials.eu/ctis-public/view/2023-509861-19-01